EU clinical trial 2024-516316-13-00: Window-of-opportunity study of chemo-immunotherapy in patients with resectable Merkel Cell Carcinoma prior to surgery: the MERCURY trial
Protocol code: MERCURY
Sponsor: Fondazione GONO G.I. (Patient organisation/association). Phase: Therapeutic exploratory (Phase II). Countries: Italy (ongoing, recruitment ended).
Therapeutic area(s): Diseases [C] - Neoplasms [C04]
Gender: Female, Male. Age: 18-64 years, 65+ years. Enrolment: 36.
Status: Ongoing, recruitment ended. Start date (EU): 2025-01-21. Decision date: 2025-01-21. Results received: No. Last updated: 2026-06-03.

Condition(s): Merkel cell carcinoma without metastases in other organs and surgically resectable
Product: ZYNYZ 500 mg concentrate for solution for infusion, ETOPOSIDE, CARBOPLATIN, CISPLATIN

Primary endpoint: The study primary endpoint will be the pathological complete response rate or pCR rate, defined as the percentage of patients, relative to the total of enrolled subjects in the intention-to-treat population, who will achieve a pathological complete response, as per central pathological review. Pathological complete response will be defined as the absence of residual viable invasive cancer on evaluation of the complete resected tumor specimen and all sampled regional lymph nodes.
Endpoint(s): Safety and tolerability will be assessed in terms of AEs (including SAEs), laboratory data, vital signs, ECGs, and exposure, that will be collected for all patients enrolled in the trial and receiving retifanlimab plus platinum-etoposide chemo-immunotherapy regimen., Quality of life will be defined by a series of Patient Reported Outcomes (PROs) assessed by the completion of quality-of-life questionnaires, FACT-M Questionnaire and EQ-5D-5L, during the preoperative treatment phase. All PROs analyses will be based on the Fatigue Assessment Scale (FAS), The transcriptional tumor/microenvironmental changes induced by the short-course preoperative chemo-immunotherapy study regimen will be resolved spatially by the evaluation of the gene expression profiles in different tumor compartments in matching pre- and post-treatment samples., The correlation of pCR with ctDNA mutational profiles and its clearance after the short-course preoperative treatment will be assessed by using ultra-deep whole-exome sequencing with Unique Molecular Identifiers to evaluate with high accuracy the presence of ctDNA obtained from the longitudinally collected liquid biopsies with high accuracy, The correlation of tumor Merkel cell polyomavirus (MCPyV) status and PD-L1 expression of with the activity of the short-course preoperative chemo-immunotherapy study regimen will be done assessing MCPyV on matching tumor tissue sections collected pre- and post-treatment. The evaluation inhibitory receptors and ligands (PD-1, PD-L) will be carried out in the malignant cells and in the stroma cells, Relapse Free Survival will be defined as the time from enrollment to the first documentation of disease recurrence or death due to any cause, whichever occurs first. RFS will be censored on the date of the last follow-up visit documenting absence of disease for patients who are alive, on study and disease free at the time of the analysis, Overall survival will be defined as the time from enrollment to the date of death due to any cause. For patients still alive at the time of analysis, the OS time will be censored on the last date the patients were known to be alive

Source: https://euclinicaltrials.eu/ctis-public/view/2024-516316-13-00